EU clinical trial 2023-504567-17-00: Safety and efficacy of botulinum toxin A in patients with trigeminal neuralgia: a double-blind, randomized, placebo-controlled, parallel-group trial and investigation of neuro-inflammatory biomarkers as predictors of efficacy
Sponsor: Rigshospitalet (Hospital/Clinic/Other health care facility). Phase: Therapeutic confirmatory (Phase III). Countries: Denmark (ongoing, recruiting).
Therapeutic area(s): Diseases [C] - Nervous System Diseases [C10]
Gender: Female, Male. Age: 18-64 years, 65+ years. Enrolment: 80.
Status: Ongoing, recruiting. Start date (EU): 2023-11-15. Decision date: 2023-08-10. Results received: No. Last updated: 2026-01-29.

Condition(s): Trigeminal neuralgia
Product: Natriumklorid Fresenius Kabi 9 mg/ml, spädningsvätska för parenteral användning, BOTOX, pulver til injektionsvæske, opløsning 100 Allergan-enheder

Primary endpoint: The proportion of responders in botulinum toxin A (BTX-A) and placebo group during the evaluation period (week 2 to 5) compared with baseline (week -4 to -1) (see protocol for definition of responders).
Endpoint(s): The degree of change in inflammatory biomarkers in responders versus non-responders in BTX-A and placebo group., The difference in inflammatory biomarkers between the symptomatic side and the asymptomatic side., The proportion of subjects reaching ≥50% reduction in mean ADP during the evaluation period (week 2 to 5) compared with baseline (week -4 to -1)., The proportion of subjects reaching ≥75% reduction in mean ADP during the evaluation period (week 2 to 5) compared with baseline (week -4 to -1)., The proportion of subjects reaching ≥30% reduction in mean ADP during week 9 to 12 compared with baseline (week -4 to -1)., Change in mean number of daily pain paroxysms during the evaluation period (week 2 to 5) and week 9 to 12 compared with baseline (week -4 to -1) in BTX-A and placebo group., Proportion of subjects with a PGI-C scale response of “much improved” or “very much improved” at week 5 in BTX-A group and placebo group., Change from baseline to week 5 in the PENN-FPS-R score in BTX-A and placebo group., Proportion of subjects correctly guessing whether they received BTX-A or placebo., Proportion of dropouts caused by increased intake of trigeminal neuralgia medication or use of prohibited rescue medication in botulinum toxin A group compared to the placebo group., Proportion of subjects with side-effects registered in weeks 2 to 5 during treatment with botulinum toxin A compared with placebo

Source: https://euclinicaltrials.eu/ctis-public/view/2023-504567-17-00